EU clinical trial 2024-519107-10-00: HeArt Rate and quality of Life in transthyrEtin cardiac amYloidosis (HARLEY)
Sponsor: Universita' Degli Studi Di Genova (Educational Institution). Phase: Therapeutic use (Phase IV). Countries: Italy (authorised, recruitment pending).
Therapeutic area(s): Diseases [C] - Cardiovascular Diseases [C14]
Gender: Female, Male. Age: 18-64 years, 65+ years. Enrolment: 104.
Status: Authorised, recruitment pending. Decision date: 2025-05-27. Results received: No. Last updated: 2025-05-27.

Condition(s): transthyretin cardiac amyloidosis

Source: https://euclinicaltrials.eu/ctis-public/view/2024-519107-10-00